EU clinical trial 2024-518869-99-00: Efficacy and safety of Silycus® in Cushing’s disease: a multicenter, single arm, open label, dose titration, proof of concept study (Silycus®-21)
Protocol code: SILYCUS-21
Sponsor: Istituto Biochimico Italiano Giovanni Lorenzini S.p.A. (Pharmaceutical company). Phase: Therapeutic exploratory (Phase II). Countries: Italy (ongoing, recruitment ended).
Therapeutic area(s): Diseases [C] - Hormonal diseases [C19]
Gender: Female, Male. Age: 18-64 years, 65+ years. Enrolment: 15.
Status: Ongoing, recruitment ended. Start date (EU): 2025-11-17. Decision date: 2024-11-26. Results received: No. Last updated: 2025-11-14.

Condition(s): Cushing's disease
Product: Silycus®

Primary endpoint: Efficacy of silibinin will be assessed on UFC, late night salivary cortisol levels and suppression with low dose dexamethasone., The composite endpoint comprises: the percentage of patients in whom UFC normalized or decreased by at least 50% compared to pretreatment values, the percentage of patients with elevated late night salivary cortisol at baseline in whom salivary cortisol normalized and percentage of patients who failed to suppress after low dose dexamethasone at baseline in whom normal suppression was restored. Efficacy will be assessed after 12 weeks of administration.
Endpoint(s): Establish the effect of Silycus® on clinical signs and symptoms of Cushing’s disease. These effects, i.e. changes in body weight, blood pressure, glucose control, electrolyte derangements, leukocytosis, will be assessed after 12 weeks administration, Analysis of safety of Silycus® administration based on frequency and severity of adverse events, Evaluation of the PK profile of silibinin in patients with Cushing’s disease (after the first dose, uptitration and at steady state)

Source: https://euclinicaltrials.eu/ctis-public/view/2024-518869-99-00